EU clinical trial 2024-510589-17-00: Randomized, controlled, multicenter Phase I/II study comparing the safety and immunogenicity of a booster dose of an intranasal COVID-19 vaccine expressing SARS-CoV-2 N/S recombinant proteins with a booster dose of COVID-19 mRNA vaccine in healthy adults
Protocol code: DR230330 – ANRS0514s
Sponsor: Inserm, Centre Hospitalier Regional Universitaire De Tours (Laboratory/Research/Testing facility, Hospital/Clinic/Other health care facility). Phase: Phase I and Phase II (Integrated)- First administration to humans. Countries: France (ongoing, recruiting).
Therapeutic area(s): Diseases [C] - Virus Diseases [C02]
Gender: Female, Male. Age: 18-64 years. Enrolment: 238.
Status: Ongoing, recruiting. Start date (EU): 2025-05-09. Decision date: 2025-01-27. Results received: No. Last updated: 2025-09-05.

Condition(s): Healthy volunteers
Product: Comirnaty JN.1 30 micrograms/dose dispersion for injection COVID-19 mRNA Vaccine, LVT-001

Primary endpoint: Phase I: Proportion of participants experiencing an immediate AE within an hour and half following vaccine administration., Phase I: Proportion of participants experiencing solicited local reactogenicity and systemic signs and symptoms for 7 days and 14 days respectively following vaccination., Phase I: Proportion of participants experiencing an unsolicited AE up to 28 days post administration., Phase I: Proportion of participants experiencing serious adverse events (SAEs), serious adverse reactions (SARs), suspected unexpected serious adverse reactions (SUSARs) and adverse events of special interest (AESI) respectively throughout the trial period., Phase II: Crude variation of the mucosal humoral immune response specific to the vaccine N/S recombinant protein measured by ELISA (Geometric Mean Titers (±SD)) in each arm: IgA from nose swabs between D0 and D28.
Endpoint(s): Crude variation of the mucosal humoral immune response specific to the vaccine N/S recombinant protein measured by ELISA (Geometric Mean Titers (±SD)): IgA from nose swabs between D0 and D7 (Phase I), D14, D28 (Phase I), M3, M6 and M12, respectively., Neutralizing capacity of the mucosal humoral immune response specific to the vaccine N/S recombinant protein measured by PRNT and VLP assays at D0, D7 (Phase I), D14, D28, M3, M6, M12, respectively: Neutralizing Ig from nose swabs., Crude variation of the systemic humoral immune response specific to the vaccine N/S recombinant protein measured by ELISA (Geometric Mean Titers (±SD)): Serum anti-S and anti-N IgG at D0, D7 (Phase I), D14, D28, M3, M6, M12, respectively., Neutralizing capacity of the systemic humoral immune response specific to the vaccine N/S recombinant protein measured by PRNT and VLP assays at D0, D7 (Phase I), D14, D28, M3, M6, M12: Neutralizing serum IgG., Percentage of responders against N and S antigens, respectively, measured by ELISpot SARS-CoV-2 assay at D0, D7 (Phase I) and D14, D28, M3, M6, M12: The quantification of IFN-gamma specifically secreted by T lymphocytes following exposure to N and S antigens will be performed on a subset of participants recruited only at Tours site for feasibility reasons. Phase I: 6 participants in each dose group. Phase II: 40 participants, Proportion of participants with COVID-19 infections confirmed by a positive PCR test or a positive antigen test between D0 and M12 in each arm., Description of variant types identified on participants with a positive PCR test after vaccination., Proportion of participants with serious COVID-19 infections defined as a hospitalization and/or death due to the COVID-19 between D0 and M12 in each arm., Phase II: Proportion of participants experiencing an immediate AE within one hour following vaccine administration., Phase II: Proportion of participants experiencing solicited local reactogenicity and systemic signs and symptoms for 7 days and 14 days respectively following vaccination., Phase II: Proportion of participants experiencing an unsolicited AE up to 28 days post administration., Phase II: Proportion of participants experiencing serious adverse events (SAEs), serious adverse reactions (SARs), suspected unexpected serious adverse reactions (SUSARs) and adverse events of special interest (AESI) respectively throughout the trial period.

Source: https://euclinicaltrials.eu/ctis-public/view/2024-510589-17-00